EU clinical trial 2024-517417-32-00: A STUDY OF EFFICACY AND SAFETY OF LONG-ACTING LOW DOSE ROPEGINTERFERON IN PATIENTS WITH CHRONIC MYELOID LEUKEMIA TREATED WITH BOSUTINIB FROM DIAGNOSIS: A RANDOMIZED PROSPECTIVE TRIAL (BosuPeg)
Protocol code: BosuPeg
Sponsor: St. Olavs Hospital HF (Hospital/Clinic/Other health care facility). Phase: Therapeutic exploratory (Phase II). Countries: Sweden (ongoing, recruitment ended), Denmark (ongoing, recruitment ended), Finland (ongoing, recruitment ended), Norway (ongoing, recruitment ended).
Therapeutic area(s): Diseases [C] - Neoplasms [C04]
Gender: Female, Male. Age: 18-64 years, 65+ years. Enrolment: 164.
Status: Ongoing, recruitment ended. Start date (EU): 2018-11-22. Decision date: 2024-11-28. Results received: No. Last updated: 2026-06-01.
Decision dates by country: FI: 2024-11-29, SE: 2024-11-29, NO: 2024-11-28, DK: 2024-11-28

Condition(s): CHRONIC MYELOID LEUKEMIA
Product: Besremi 250 micrograms/0.5 mL solution for injection in pre-filled pen, BOSUTINIB

Primary endpoint: To compare the rate of molecular response 4 (MR4 ) at 12 months in each treatment arm.
Endpoint(s): The rates of molecular responses MR2 , MR3 , MR4 , MR4.5, at 1, 2, 3, 6, 9, 12, 15, 18, 21, 24 months and every 6 months thereafter in each arm., The cumulative incidence of MR3 , MR4 , MR4.5 within the same periods in each arm, The rates of complete cytogenetic response (CCyR) at 3, 6, 12 months., The rates of undetectable molecular responses for the patients who achieved an MR4 and an MR4.5 in each arm., Time to and duration of CCyR, MR2 , MR3 , MR4 ,MR4.5 ., The proportion of patients eligible for randomization after 3 months of BOS, The rates and characteristics of severe adverse events (SAE) and adverse events (AE) related to BOS and RoPegIFN, from clinical and biological assessments: type and grade according to the NCI CTCAE v4.03., The dose intensity of RoPegIFN and BOS administered during the first two years of study treatment. The cumulative incidence of discontinuation of the therapies. Reasons of discontinuation., Other endpoints for the BosuPeg substudy: -Biomarkers of response, failure and toxicity. A) Fraction and phenotype of leukemic cells in the stem cell and progenitor cell compartment at debut and 3 and 12 months of treatment. B)Phenotype and function of immune cells at debut and 3 and 12 months of treatment. C)Non-CR-ABL mutations at debut and during treatment D)TCR clonality at debut and during treatment E)Changes in plasma cytokine profile during treatment, Other endpoints for the BosuPeg substudy: - Identification of novel potential targets for therapy of CML, The progression free survival, the event-free survival and the overall survival. Occurrence and type of BCR-ABL TK mutation, Quality of life assessment by QLQC30 and CML24 questionnaires at key time point (Day 1, M3, M6, M12, M24, at planned BOS-discontinuation, 6 and 24 months post discontinuation as well as at restart after discontinuation and 6 months after restart)., The proportion of patients achieving a durable deep molecular response and being eligible for treatment discontinuation at month 48–60 after minimally 2 years in continuous MR4 or better, The proportion of patients in treatment free remission after 6, 12, 24 and 36 months of BOS discontinuation.

Source: https://euclinicaltrials.eu/ctis-public/view/2024-517417-32-00